EU clinical trial 2023-507419-37-00: A Phase 3 randomized, open-label, multicenter study of isatuximab (SAR650984) in combination with lenalidomide and dexamethasone versus lenalidomide and dexamethasone in patients with high-risk smoldering multiple myeloma
Protocol code: EFC15992
Sponsor: Sanofi-Aventis Recherche & Developpement (Pharmaceutical company). Phase: Therapeutic confirmatory (Phase III). Countries: Denmark (ongoing, recruitment ended), Germany (ongoing, recruitment ended), Hungary (ongoing, recruitment ended), Greece (ongoing, recruitment ended), Norway (ongoing, recruitment ended), Italy (ongoing, recruitment ended), France (ongoing, recruitment ended), Czechia (ongoing, recruitment ended), Poland (ongoing, recruitment ended), Spain (ongoing, recruitment ended), Lithuania (ongoing, recruitment ended).
Therapeutic area(s): Diseases [C] - Neoplasms [C04]
Gender: Female, Male. Age: 18-64 years, 65+ years. Enrolment: 272.
Status: Ongoing, recruitment ended. Start date (EU): 2020-06-25. Decision date: 2024-02-14. Results received: No. Last updated: 2025-10-06.
Decision dates by country: PL: 2024-03-15, LT: 2024-02-20, FR: 2024-02-14, ES: 2024-02-19, CZ: 2024-02-16, DK: 2024-02-15, DE: 2024-02-19, GR: 2024-02-23, HU: 2024-02-14, IT: 2024-02-16, NO: 2024-02-16

Condition(s): Plasma cell myeloma
Product: Revlimid 10 mg hard capsules, DIPHENHYDRAMINE, Revlimid 20 mg hard capsules, Dexamethasone 3.3 mg/ml solution for injection, Zelvina 5 mg hard capsules, Revlimid 10 mg hard capsules, Isatuximab, Revlimid 25 mg hard capsules, Zelvina 25 mg hard capsules, Revlimid 5 mg hard capsules, Revlimid 15 mg hard capsules, Zelvina 10 mg hard capsules, PARACETAMOL, Zelvina 20 mg hard capsules, MONTELUKAST, METHYLPREDNISOLONE, Revlimid 5 mg hard capsules, Revlimid 20 mg hard capsules, Zelvina 15 mg hard capsules, Isatuximab, Revlimid 15 mg hard capsules, Dexamethason 8 mg JENAPHARM®, Dexamethason 4 mg JENAPHARM®, Revlimid 25 mg hard capsules, DexaGalen® 8 mg injekt Injektionslösung

Primary endpoint: Number of participants with treatment-emergent: adverse events (AEs) and serious adverse events - Safety Run-in Part, Plasma concentration of isatuximab during the treatment period: - Safety Run-in Part, Receptor density/receptor occupancy - Safety Run-in Part, Progression-free survival (PFS) - Randomized Phase 3 Part
Endpoint(s): Overall response rate (ORR) - Safety Run-in Part, Duration of response (DOR) - Safety Run-in Part, Minimal residual disease (MRD) negativity -Safety Run-in Part, Time to diagnostic (SLiM CRAB) progression or death - Safety Run-in Part, Time to first-line treatment for multiple myeloma (MM) - Safety Run-in Part, Number of participants with anti-drug antibodies (ADA) against isatuximab - Safety Run-in Part, PFS in participants with chromosomal abnormalities - Safety Run-In Part, Overall Survival (OS) in participants with chromosomal abnormalities - Safety Run-In Part, Minimal residual disease (MRD) negativity – Randomized Phase 3 Part, Sustained MRD negativity - Randomized Phase 3 Part, Second PFS (PFS2) - Randomized Phase 3 Part, OS - Randomized Phase 3 Part, Complete response (CR) rate - Randomized Phase 3 Part, Overall Response Rate (ORR) – Randomized Phase 3 Part, Duration of response (DOR) – Randomized Phase 3 Part, Time to diagnostic (SLiM CRAB) progression - Randomized Phase 3 Part, Time to biochemical progression - Randomized Phase 3 Part, Time to first-line treatment for MM- Randomized Phase 3 Part, PFS in participants with chromosomal abnormalities - Randomized Phase 3 Part, OS in participants with chromosomal abnormalities - Randomized Phase 3 Part, Number of participants with Treatment- emergent adverse events (AEs) and serious adverse events - Randomized Phase 3 Part, Plasma concentration of isatuximab (Ctrough)- Safety Run-in and Randomized Phase 3 Part, Concentration observed at the end of intravenous infusion.(Ceoi)- Safety Run-in Part, Number of participants with Incidence of anti- drug antibodies (ADA) against isatuximab-, European Organization for Research and Treatment of Cancer (EORTC) QLQ-C30 - Randomized Phase 3, EORTC QLQ-MY20 - Randomized Phase 3 Part, EQ-5D-5L - Randomized Phase 3 Part, Randomized Phase 3: HRUPQ - Randomized Phase 3 Part, Patient's Qualitative Assessment of Treatment Version 2 (PQAT-v2) - Randomized Phase 3 Part

Source: https://euclinicaltrials.eu/ctis-public/view/2023-507419-37-00